EU clinical trial 2024-513627-16-01: Phase 1/2 dose escalation and cohort expansion study evaluating MCLA-158 (petosemtamab) as single agent or in combination in advanced solid tumors
Protocol code: MCLA-158-CL01
Sponsor: Merus B.V. (Pharmaceutical company). Phase: Phase I and Phase II (Integrated)- First administration to humans. Countries: Belgium (ongoing, recruiting), Netherlands (ongoing, recruiting), Spain (ongoing, recruiting), France (ongoing, recruiting), Italy (ongoing, recruiting).
Therapeutic area(s): Diseases [C] - Neoplasms [C04]
Gender: Female, Male. Age: 18-64 years, 65+ years. Enrolment: 408.
Status: Ongoing, recruiting. Start date (EU): 2018-03-28. Decision date: 2024-10-22. Results received: No. Last updated: 2026-07-17.
Decision dates by country: IT: 2025-10-21, FR: 2024-10-24, ES: 2024-10-25, NL: 2024-10-22, BE: 2024-10-24

Condition(s): Malignant solid tumor, Colorectal cancer metastatic
Product: IRINOTECAN, OXALIPLATIN, CALCIUM FOLINATE, KEYTRUDA 25 mg/mL concentrate for solution for infusion, FLUOROURACIL

Primary endpoint: Objective Response Rate (ORR), Frequency and severity of adverse events, serious adverse events, treatment discontinuations and modifications
Endpoint(s): Pharmacokinetic parameters (CEOI, Cmax, C0h, AUC, CL, Vss, tmax and t1/2,) and population pharmacokinetics, Progression-Free Survival (PFS) and Duration of Response (DOR), Overall Survival (OS)

Source: https://euclinicaltrials.eu/ctis-public/view/2024-513627-16-01